EU clinical trial 2024-517568-48-00: A Phase 3, Double-blind, Randomized, Placebo-controlled, Multicenter Study to Evaluate the Efficacy and Safety of Ravulizumab Administered Intravenously in Adult Participants at High Risk of Delayed Graft Function after Kidney Transplantation
Protocol code: ALXN1210-DGF-321
Sponsor: Alexion Pharmaceuticals Inc. (Pharmaceutical company). Phase: Therapeutic confirmatory (Phase III). Countries: Poland (ongoing, recruiting), Italy (ongoing, recruiting), Germany (ongoing, recruiting), Austria (ongoing, recruiting), Portugal (ongoing, recruiting), Czechia (ongoing, recruiting), Spain (ongoing, recruiting), France (authorised, recruitment pending).
Therapeutic area(s): Diseases [C] - Immune System Diseases [C20]
Gender: Female, Male. Age: 18-64 years, 65+ years. Enrolment: 170.
Start date (EU): 2025-07-21. Decision date: 2025-06-18. Results received: No. Last updated: 2026-07-28.
Decision dates by country: IT: 2025-06-19, CZ: 2025-06-18, ES: 2025-06-26, FR: 2026-03-09, PT: 2025-06-18, DE: 2025-06-23, PL: 2025-06-24, AT: 2025-06-22

Condition(s): Delayed Graft Function after Kidney Transplantation
Product: Anti C5 Complement mAb Placebo, Ultomiris 1,100 mg/11 mL concentrate for solution for infusion

Primary endpoint: Time to freedom from dialysis through 90 days post-transplant
Endpoint(s): DGF incidence: Requirement of at least 1 dialysis session within the first 7 days post-transplant, Number of dialysis sessions through 90 days post-transplant, Time to first occurrence of eGFR ≥ 30 mL/min/1.73 m2 through 90 days post-transplant

Source: https://euclinicaltrials.eu/ctis-public/view/2024-517568-48-00